EU clinical trial 2025-520551-84-00: Preventing oxidative stress-induced ischemic injury and systemic inflammation complications during and after invasive cardiac surgery with alkaline phosphatase (APPIRED III)
Protocol code: NUH-ALS-2015-04
Sponsor: Alloksys Life Sciences B.V. (Pharmaceutical company). Phase: Therapeutic confirmatory (Phase III). Countries: Belgium (authorised, recruitment pending), Austria (authorised, recruitment pending).
Therapeutic area(s): Phenomena and Processes [G] - Immune system processes [G12]
Gender: Female, Male. Age: 18-64 years, 65+ years. Enrolment: 500.
Status: Authorised, recruitment pending. Decision date: 2025-01-30. Results received: No. Last updated: 2025-08-28.
Decision dates by country: BE: 2025-01-30, AT: 2025-01-30

Condition(s): systemic inflammation as side-effect of heart-lung machine during cardiac surgery
Product: RESCAP iv, The placebo is identical with the IMP, but without active substance

Primary endpoint: • Stop administering placebo but continue with experimental drug if AKI (defined by AKIN) is significantly lower in the experimental group or mortality is significantly lower in the experimental group., • Stop if all cause mortality, cardiac mortality, acute kidney injury, or the primary compound outcome is significantly higher in the experimental group, • Stop if more than 5% of patients have a serious adverse/allergic reaction to the administration of the drug

Source: https://euclinicaltrials.eu/ctis-public/view/2025-520551-84-00